EU clinical trial 2023-509338-21-00: C1131003 - AN INTERVENTIONAL PHASE 2, OPEN-LABEL, MULTI-CENTER STUDY TO EVALUATE SAFETY AND EFFICACY OF PF-06835375 IN ADULT PARTICIPANTS WITH MODERATE TO SEVERE PRIMARY IMMUNE THROMBOCYTOPENIA
Protocol code: C1131003
Sponsor: Pfizer Inc. (Pharmaceutical company). Phase: Therapeutic exploratory (Phase II). Countries: Poland (ongoing, recruitment ended), Czechia (ongoing, recruitment ended), Hungary (ongoing, recruitment ended).
Therapeutic area(s): Diseases [C] - Hemic and Lymphatic Diseases [C15]
Gender: Female, Male. Age: 18-64 years, 65+ years. Enrolment: 69.
Status: Ongoing, recruitment ended. Start date (EU): 2025-05-28. Decision date: 2024-06-03. Results received: No. Last updated: 2026-07-31.
Decision dates by country: PL: 2024-06-10, HU: 2024-06-03, CZ: 2024-06-06

Condition(s): Primary immune thrombocytopenia
Product: PF-06835375 Injection, DIPHENHYDRAMINE HYDROCHLORIDE

Primary endpoint: Log2 (platelet count) at Week 12 (6 mg cohort), and at Week 16 for the 18 mg, 50 mg and 150 mg cohorts.
Endpoint(s): Modified overall response (mOR) at Week 12 (6 mg cohort) and at Week 16 for the 18 mg, 50 mg and 150 mg cohorts., Complete response (CR) at Week 12 (6 mg cohort), and at Week 16 for the 18 mg, 50 mg and 150 mg cohorts., Incidence of AEs as characterized by type, frequency, severity, timing, seriousness, and relationship to study intervention, Day 1 through end of study, Log2 (platelet count) over time, Modified response (mOR) over time, Complete response (CR) over time, Absolute values and change of platelet count from baseline over time, Absolute values and change from baseline of circulating B and cTfh cell counts over time

Source: https://euclinicaltrials.eu/ctis-public/view/2023-509338-21-00